EU clinical trial 2023-509351-13-00: Duration of peripheral nerve blocks in opioid tolerant individuals - A volunteer blinded matched case-control study
Sponsor: Region Midtjylland (Hospital/Clinic/Other health care facility). Phase: Therapeutic use (Phase IV). Countries: Denmark (ended).
Therapeutic area(s): Analytical, Diagnostic and Therapeutic Techniques and Equipment [E] - Anesthesia and Analgesia [E03]
Gender: Female, Male. Age: 18-64 years, 65+ years. Enrolment: 40.
Status: Ended. Start date (EU): 2024-06-11. End date (EU): 2025-12-16. Decision date: 2024-03-11. Results received: No. Last updated: 2024-03-11.

Condition(s): Postoperative pain
Product: Lidokain ”Mylan”, injektionsvæske, opløsning

Primary endpoint: The difference between group A and B in duration of sensory nerve block
Endpoint(s): The difference between group A and B in onset time of sensory block measured as T0 to T2., The difference between group A and B in motor block onset time measured as T0 to T1., The difference between group A and B in duration of motor nerve block measured as T0 to T3.

Source: https://euclinicaltrials.eu/ctis-public/view/2023-509351-13-00